EU clinical trial 2022-501456-28-00: An international prospective umbrella trial for children with atypical teratoid/rhabdoid tumours (ATRT) including a randomized phase III study evaluating the non-inferiority of three courses of high-dose chemotherapy (HDCT) compared to focal radiotherapy as consolidation therapy
Protocol code: SIOPEATRT01
Sponsor: GPOH gGmbH (Patient organisation/association). Phase: Therapeutic confirmatory (Phase III). Countries: Norway (ongoing, recruiting), Netherlands (ongoing, recruiting), Denmark (ongoing, recruiting), Germany (ongoing, recruiting), Belgium (ongoing, recruiting), Spain (authorised, recruiting), Sweden (ongoing, recruiting), Finland (ongoing, recruiting), Hungary (authorised, recruiting), Czechia (authorised, recruiting), Italy (ongoing, recruiting), France (ongoing, recruiting).
Therapeutic area(s): Diseases [C] - Neoplasms [C04]
Gender: Female, Male. Age: 0-17 years. Enrolment: 301.
Start date (EU): 2020-07-20. Decision date: 2023-07-07. Results received: No. Last updated: 2026-07-08.
Decision dates by country: NL: 2023-07-07, NO: 2023-07-12, BE: 2024-01-08, DE: 2023-08-08, DK: 2023-07-07, IT: 2024-09-16, FR: 2024-09-25, SE: 2024-01-29, HU: 2024-04-26, CZ: 2024-05-20, FI: 2024-02-20, ES: 2024-04-29

Condition(s): atypical teratoid/rhabdoid tumours (ATRT)
Product: Vincristinsulfat-TEVA® 1 mg/ml Injektionslösung, Methotrexate 50mg/2 ml Injection., Doxorubicinhydrochlorid Teva® 2 mg/ml Konzentrat zur Herstellung einer Infusionslösung, Cyclophosphamide 500 mg Powder for Solution for Injection or Infusion, Carboplatin 10 mg/ml Konzentrat zur Herstellung einer Infusionslösung, TEPADINA 15 mg powder for concentrate for solution for infusion, HOLOXAN 500 mg Pulver zur Herstellung einer Injektionslösung, LYOVAC*-COSMEGEN® 0,5mg Pulver zur Herstellung einer Infusionslösung, Etoposide 20 mg/ml Concentrate for Solution for Infusion

Primary endpoint: Overall survival (2-year follow-up, for Part A non-inferiority of the HDCT arm)
Endpoint(s): specific for Part A: Test the non-inferiority, as evaluated by OS (5-year follow-up), of three courses of HDCT compared to focal RT plus conventional chemotherapy, specific for Part A: Compare the neurocognitive outcome in the two treatment arms before randomization, 2 and 5 years after randomization, including demonstration and quantification of the superiority of neuropsychological performance in children and adolescents with ATRT following treatment by HDCT, compared to those treated with RT; identification of risk factors for differences in outcome, specific for Part A: Compare the quality of life in the two treatment arms before randomization, 2 and 5 years following randomization, specific for Part A: Compare event-free survival (EFS), progression-free survival (PFS) and OS between arms and to historical controls, specific for Part A: Compare the incidence and severity of Adverse Events (AEs) in each of the arms, specific for Part A: Compare the incidence and severity of late effects in each of the arms, specific for Part A: Assess the response to induction chemotherapy and compare it with that of historical controls, specific for Part B: Assess the efficacy, as evaluated by OS (5-year follow-up), of three courses of HDCT as a consolidation measure following conventional-type chemotherapy in children with ATRT aged <12 months at the time of HDCT and not eligible for randomization in Part A of this protocol, compared to historical controls., specific for Part C: Assess the efficacy, as evaluated by OS (5-year follow-up), of RT as a consolidation measure combined with conventional-type chemotherapy in children aged ≥36 months with ATRT and not eligible for randomization in Part A of this protocol, compared to historical controls, Parts B and C: Assess the neurocognitive outcome in the cohorts following induction at diagnosis, 2 and 5 years after diagnosis, Parts B and C: Assess the quality of life in the cohort following induction at diagnosis, 2 and 5 years after diagnosis, Parts B and C: Compare EFS and PFS to that of historical controls, Parts B and C: Assess the incidence and severity of AEs, Parts B and C: Assess the incidence and severity of late effects, Parts B and C: Assess the response to induction chemotherapy and compare it with that of historical controls

Source: https://euclinicaltrials.eu/ctis-public/view/2022-501456-28-00